EU clinical trial 2025-521497-34-00: Long-term follow-up of patients treated with GD2IL18CART
Protocol code: UniMS24_0003
Sponsor: Universitaet Muenster (Educational Institution). Phase: Human Pharmacology (Phase I)- First administration to humans. Countries: Germany (ongoing, recruiting).
Therapeutic area(s): Diseases [C] - Neoplasms [C04]
Gender: Female, Male. Age: 0-17 years, 18-64 years, 65+ years. Enrolment: 20.
Status: Ongoing, recruiting. Start date (EU): 2025-10-06. Decision date: 2025-09-02. Results received: No. Last updated: 2026-06-25.

Condition(s): Neuroblastoma, Advanced breast cancer, Ewing sarcoma, Osteosarcoma
Product: GD2IL18CART

Primary endpoint: Percentage of patients with late-onset adverse reactions (AR), serious adverse events (SAE), serious adverse reactions (SAR) and adverse events of special interest (AESI) including relapse or progression of the underlying disease, life-threatening infections, death due to any cause, new and secondary malignancies
Endpoint(s): Pediatric patients: Height and weight, Tanner status, Percentage of patients who relapse or progress since enrollment and rate of surviving patients, Probabilities of overall survival, disease-free survival, Duration of response, relapse rate and time to relapse, Percentage of patients with detectable transgene levels. If results of 2 consecutive years are negative for an individual patient, further sampling will not be continued for this patient.

Source: https://euclinicaltrials.eu/ctis-public/view/2025-521497-34-00